EU clinical trial 2024-511259-16-00: Phase 1 Trial of the Safety, Pharmacokinetics, Pharmacodynamics, and Preliminary Clinical Activity of RP-1664 in Participants with Advanced Solid Tumors
Protocol code: RP-1664-01
Sponsor: Repare Therapeutics USA Inc. (Pharmaceutical company). Phase: Human Pharmacology (Phase I)- First administration to humans. Countries: Denmark (ended).
Therapeutic area(s): Diseases [C] - Neoplasms [C04]
Gender: Female, Male. Age: 0-17 years, 18-64 years, 65+ years. Enrolment: 15.
Status: Ended. Start date (EU): 2025-02-24. End date (EU): 2025-07-31. End date: 2025-08-27. Decision date: 2024-07-16. Results received: No. Last updated: 2025-02-24.
Decision dates by country: DK: 2024-08-02

Condition(s): Advanced Solid Tumors

Primary endpoint: Incidence and severity of treatment-emergent adverse events (TEAEs), Dose and schedule based on safety, PK, pharmacodynamic, and available efficacy data
Endpoint(s): Plasma concentrations of RP-1664 with calculation of maximum observed plasma concentration (Cmax), time to maximum observed plasma concentration (Tmax), minimum observed plasma concentration (Cmin), area under the plasma concentration-time curve (AUC), elimination half life (t1/2), fraction excreted in urine (for food effect participants only) and other parameters as appropriate, Objective response rate (ORR) according to Response Evaluation Criteria in Solid Tumors (RECIST) v1.1 or International Neuroblastoma Response Criteria (INRC; for participants with neuroblastoma). Overall response rate. Clinical benefit rate (CBR). Best percent change in tumor size from baseline. Progression-free survival (PFS)

Source: https://euclinicaltrials.eu/ctis-public/view/2024-511259-16-00